EU clinical trial 2024-515664-31-00: Phase 1 study to evaluate [18F]ACI-15916 as a potential PET radioligand for imaging α-synuclein deposits in the brain of patients with suspected α-synuclein pathology compared with healthy volunteers
Protocol code: ACI-15916-PD-2401
Sponsor: AC Immune S.A. (Pharmaceutical company). Phase: Human Pharmacology (Phase I)- First administration to humans. Countries: Sweden (ongoing, recruiting).
Therapeutic area(s): Diseases [C] - Nervous System Diseases [C10]
Gender: Female, Male. Age: 18-64 years, 65+ years. Enrolment: 46.
Status: Ongoing, recruiting. Start date (EU): 2025-03-04. Decision date: 2025-02-26. Results received: No. Last updated: 2025-07-25.

Condition(s): Parkinson's Disease, Dementia with Lewy Bodies, Multiple System Atrophy

Source: https://euclinicaltrials.eu/ctis-public/view/2024-515664-31-00